EU clinical trial 2024-513949-37-00: A prospective multicenter phase 2 study of the chemotherapy-light combination of intravenous rituximab with the antibody-drug conjugate polatuzumab vedotin and the bispecific antibody glofitamab in previously untreated aggressive B-cell lymphoma patients above 60 years of age ineligible for a fully dosed R-CHOP
Sponsor: Frankfurter Institut Fuer Klinische Krebsforschung IKF GmbH (Pharmaceutical company). Phase: Therapeutic exploratory (Phase II). Countries: Austria (ongoing, recruitment ended), Germany (ongoing, recruitment ended).
Therapeutic area(s): Diseases [C] - Hemic and Lymphatic Diseases [C15]
Gender: Female, Male. Age: 18-64 years, 65+ years. Enrolment: 126.
Status: Ongoing, recruitment ended. Start date (EU): 2023-03-16. Decision date: 2024-11-11. Results received: No. Last updated: 2026-04-10.
Decision dates by country: DE: 2024-11-11, AT: 2024-11-13

Condition(s): previously untreated aggressive B-cell lymphoma
Product: Glofitamab, Gazyvaro 1,000 mg concentrate for solution for infusion., MabThera 500 mg concentrate for solution for infusion, Polivy 140 mg powder for concentrate for solution for infusion.

Primary endpoint: 1 year progression-free survival (PFS) rate of first 80 patients enrolled
Endpoint(s): Event-free survival (EFS), Overall survival (OS), Response rates after 2 cycles (during target dose phase), 6 cycles (end of target dose phase before start of consolidation phase) and 12 cycles (end of treatment following completion of consolidation phase). i.e., complete remission (CR) rate, partial remission (PR) rate, overall remission rate (ORR: CR+PR), stable disease (SD) rate and progressive disease (PD) rate, Relapse rate, Conversion rate of PR to CR during target dose phase (C2-C6) and consolidation phase (C7-C12), Duration of response (DoR), Rate and type of adverse events (AEs) and serious adverse events (SAEs), Rate of secondary malignancies, Treatment-related death rate, Protocol adherence, Patient-reported outcomes for quality of life (QoL), Subgroup analysis with respect to age groups, IPI factors, IPI score, geriatric scores, sex, and CD20 expression level (as centrally assessed), Subgroup analysis for disease entities (DLBCL, rFL, HGBCL with MYC and BCL2 translocation), transcriptional subtypes (ABC vs. GCB) and genetic subtypes of DLBCL (DLBclass and LymphGen)., Identification of molecular and imaging-based (investigator vs central review of images) predictors of response and sensitivity, including TMTV at baseline, delta SUV between baseline and C2 and C6 PET/CTs, rate of mCR at C2 and C6 (defined as a Deauville score ≤ 3), Rate of minimal residual disease (MRD)-negative patients after end of target phase (before start of consolidation phase) and at end of treatment (including consolidation phase), Duration of molecular remission for MRD negative patients, Identification of molecular and imaging-based (investigator vs central review of images) predictors of PR to CR conversion., Proportion of patients in whom R-Pola-Glo medication can be administered in the outpatient setting as recommended by the safety board (judged before treatment and including modification after cycle 1 or 2) and no hospitalization occurs following 24hrs after last administration., Proportion of patients in whom R-Pola-Glo medication can be administered in the outpatient setting as recommended by the safety board (judged before treatment and including modification after cycle 1 or 2) but are hospitalized within 24hrs after last administration for timely medical assistance from treating physician for symptoms developed following treatment with R-Pola-Glo., Cycles safely administered in an outpatient setting per patient., Exploratory analysis for predictive markers for IMP-related side effects from the safety board parameter assessment at the following time points: pretreatment, post cycle 1 and post cycle 2

Source: https://euclinicaltrials.eu/ctis-public/view/2024-513949-37-00